EU clinical trial 2024-518214-11-01: InvestiGating the rOle of Growth Hormone in hepatic lipid metabolism in humans
Sponsor: Medical University Of Vienna (Educational Institution). Phase: Therapeutic exploratory (Phase II). Countries: Austria (ongoing, recruiting).
Therapeutic area(s): Phenomena and Processes [G] - Physiological processes [G07]
Gender: Female, Male. Age: 18-64 years, 65+ years. Enrolment: 30.
Status: Ongoing, recruiting. Start date (EU): 2022-01-01. Decision date: 2025-01-15. Results received: No. Last updated: 2025-01-15.

Condition(s): acromegaly, healthy
Product: SOMAVERT 20 mg powder and solvent for solution for injection, Genotropin® 12 mg/ml Pulver und Lösungsmittel zur Herstellung einer Injektionslösung

Primary endpoint: GH induced changes in metabolism of energy rich phosphates (ATP turnover)
Endpoint(s): GH induced changes in hepatic lipid content, GH induced changes in VLDL secretion, GH induced changes in de novo lipogenesis, i.e. the incorporation of D2 into VLDL-TG palmitate and lipid profiling using a DNL index, GH induced changes in the accumulation of deuterium label in lipid stores, including liver and subcutaneous adipose tissue, as measure of depot specific de novo lipogenesis, GH induced changes in resting energy expenditure, GH induced changes in body composition

Source: https://euclinicaltrials.eu/ctis-public/view/2024-518214-11-01